EU clinical trial 2022-500775-31-00: A study to investigate pharmacokinetics and safety of rupatadine (10 mg) and its active metabolites in participants with renal impairment compared to matched control participants with normal renal function.
Protocol code: DC09RUP/1/21
Sponsor: Noucor Health S.A. (Pharmaceutical company). Phase: Human Pharmacology (Phase I)- Other. Countries: Spain (ended), Portugal (ended).
Therapeutic area(s): Diseases [C] - Respiratory Tract Diseases [C08]
Gender: Female, Male. Age: 18-64 years, 65+ years. Enrolment: 48.
Status: Ended. Start date (EU): 2022-11-08. End date (EU): 2025-10-24. Decision date: 2022-08-01. Results received: No. Last updated: 2025-02-05.
Decision dates by country: ES: 2022-08-01, PT: 2022-09-08

Condition(s): Allergic rhinitis, Urticaria

Source: https://euclinicaltrials.eu/ctis-public/view/2022-500775-31-00